EU clinical trial 2023-509633-39-00: A first-in-human, open-label, multicenter Phase I/II study to evaluate the safety and anti-tumor activity of ANV600 as single agent and in combination with pembrolizumab in participants with advanced solid tumors (EXPAND-1)
Protocol code: ANV600-001
Sponsor: Anaveon AG (Pharmaceutical company). Phase: Phase I and Phase II (Integrated)- First administration to humans. Countries: Germany (ended), France (ended), Belgium (ended), Spain (ended), Netherlands (ended).
Therapeutic area(s): Diseases [C] - Neoplasms [C04]
Gender: Female, Male. Age: 18-64 years, 65+ years. Enrolment: 194.
Status: Ended. Start date (EU): 2024-08-06. End date (EU): 2026-06-02. End date: 2026-06-23. Decision date: 2024-07-17. Results received: No. Last updated: 2026-08-06.
Decision dates by country: BE: 2024-07-24, ES: 2024-09-06, NL: 2024-09-16, FR: 2024-07-17, DE: 2024-07-17

Condition(s): Advanced solid tumours
Product: ANV600, KEYTRUDA 25 mg/mL concentrate for solution for infusion

Primary endpoint: Phase I: Incidence of dose limiting toxicities (DLT) with ANV600 single agent and in combination with pembrolizumab., Phase I: Frequency and severity of treatment-emergent adverse events (TEAEs) with ANV600 and in combination with pembrolizumab., Phase II: Objective response rate (ORR) using RECIST v1.1., Phase II: Duration of response (DOR) using RECIST v1.1.
Endpoint(s): Phase I: PK parameters based on ANV600 serum levels following a single dose and after repeated dosing., Phase I: Immunogenicity as indicated by the incidence of anti-drug antibodies (ADA) and neutralizing antibodies (nAb)., Phase I: ORR using RECIST v1.1., Phase I: DOR using RECIST v1.1., Phase II: Progression-free Survival (PFS)., Phase II: Overall survival (OS)., Phase II: Frequency and severity of TEAEs with ANV600 and in combination with pembrolizumab., Phase II: PK parameters based on ANV600 serum levels following a single dose and after repeated dosing., Phase II: Immunogenicity as indicated by the incidence of ADA and nAb.

Source: https://euclinicaltrials.eu/ctis-public/view/2023-509633-39-00